EU clinical trial 2024-513366-18-00: Phase II, multicenter, open-label, randomized, controlled, open-label clinical trial to eliminate the latent reservoir of HIV-1 by administration of high doses of antiretroviral drugs.
Protocol code: DOSAGE
Sponsor: Fundacion Para La Investigacion Biomedica Del Hospital Universitario Ramon Y Cajal (Laboratory/Research/Testing facility). Phase: Therapeutic exploratory (Phase II). Countries: Spain (ongoing, recruiting).
Therapeutic area(s): Diseases [C] - Virus Diseases [C02]
Gender: Female, Male. Age: 18-64 years. Enrolment: 24.
Status: Ongoing, recruiting. Start date (EU): 2025-04-07. Decision date: 2024-09-09. Results received: No. Last updated: 2026-04-10.

Condition(s): HIV infection
Product: Lamivudina NORMON 300 mg comprimidos recubiertos con película EFG., Tivicay 50 mg film-coated tablets, CELSENTRI 300 mg film-coated tablets

Primary endpoint: - Latent cell reservoir size by measuring total and intact proviral DNA (IPDA).

Source: https://euclinicaltrials.eu/ctis-public/view/2024-513366-18-00